EU clinical trial 2026-526720-49-00: A Phase 4, Pragmatic, Randomized Trial to Evaluate the Effectiveness of An Influenza/COVID-19 Vaccine (mCombriax [mRNA-1083]) in Adults ≥ 65 Years (DAN-COMBO)
Protocol code: DAN-COMBO
Sponsor: Gentofte Hospital, Moderna Inc. (Hospital/Clinic/Other health care facility, Pharmaceutical company). Phase: Therapeutic use (Phase IV). Countries: Denmark (authorised, recruitment pending).
Therapeutic area(s): Diseases [C] - Virus Diseases [C02]
Gender: Female, Male. Age: 65+ years. Enrolment: 280000.
Status: Authorised, recruitment pending. Decision date: 2026-08-07. Results received: No. Last updated: 2026-08-07.

Condition(s): SARS-CoV-2 infection, Influenza infection
Product: Efluelda Tetra, injektionsvæske, suspension i fyldt injektionssprøjte, Spikevax JN.1 50 micrograms dispersion for injection in pre-filled syringe COVID-19 mRNA Vaccine, mCOMBRIAX dispersion for injection in pre-filled syringe Influenza and COVID-19, mRNA vaccine

Primary endpoint: The primary endpoints of the study are the occurrence of: (1) medically attended influenza and/or COVID-19; (2) influenza and/or COVID-19 hospitalization
Endpoint(s): Medically attended influenza, Influenza hospitalization, Medically attended COVID-19, COVID-19 hospitalization, All-cause cardio-respiratory hospitalization, All-cause hospitalization, All-cause respiratory tract disease hospitalization

Source: https://euclinicaltrials.eu/ctis-public/view/2026-526720-49-00